EU clinical trial 2024-513123-17-00: CO-THEIA (COMBINATION THERAPY WITH METHOTREXATE AND ADALIMUMAB FOR UVEITIS): EFFICACY, SAFETY AND COST-EFFECTIVENESS OF METHOTREXATE, ADALIMUMAB, OR THEIR COMBINATION IN NON INFECTIOUS NON ANTERIOR UVEITIS: A MULTICENTER, RANDOMIZED, PARALLEL 3 ARMS, ACTIVE-CONTROLLED, PHASE 3 OPEN LABEL WITH BLINDED OUTCOME ASSESSMENT STUDY.
Sponsor: Fundacion Para La Investigacion Biomedica Del Hospital Clinico San Carlos (Laboratory/Research/Testing facility). Phase: Therapeutic confirmatory (Phase III). Countries: Spain (ended).
Therapeutic area(s): Diseases [C] - Eye Diseases [C11]
Gender: Female, Male. Age: 18-64 years, 65+ years. Enrolment: 192.
Status: Ended. Start date (EU): 2022-01-12. End date (EU): 2025-11-26. Decision date: 2024-04-15. Results received: No. Last updated: 2025-03-03.

Condition(s): Non-infection uveitis
Product: METHOTREXATE, METHOTREXATE DISODIUM, ADALIMUMAB

Primary endpoint: Proportion of patients achieving a Good Clinical Response between the combination therapy arm and the single immunosuppressive drugs arms.
Endpoint(s): Proportion of patients achieving a Good Clinical Response by week 16, between study arms, Change from baseline of the VFQ-25 between groups, Direct and indirect cost, and Incremental Cost Effectiveness Ratios, Proportion of patients achieving each of the clinical component of the primary efficacy outcome, between study arms, Proportion of patients achieving each clinical component of the Good Clinical Response by week 16, between study arms, Evolution of the UVEDAI during follow-up, Proportion of patients achieving the primary efficacy outcome based on the commercial brand of ADA prescribed, Proportion of patients achieving the primary efficacy outcome based on the use of iv GC during the screening period, Evolution of the EQ-5D during follow-up, Change from baseline of the HADS between groups, Time to inflammatory relapse between groups, defined as the time from visit 16 weeks until end of the study, loss of follow-up or appearance of at least one of the following, in those individuals achieving a Good Clinical Response by visit 16 week, Evolution of the BCVA during follow-up, Proportion of patients developing anti-ADA antibodies (AAA) at Baseline, week 15, 27 and the FET visit, between the ADA monotherapy and the combination arm.

Source: https://euclinicaltrials.eu/ctis-public/view/2024-513123-17-00